EU clinical trial 2022-502233-25-00: A Phase 3, Randomized, Double-Blind, Placebo-Controlled Study to Evaluate the Efficacy, Safety, and Tolerability of Valbenazine as Adjunctive Treatment in Subjects with Schizophrenia
Protocol code: NBI-98854-ATS3020
Sponsor: Neurocrine Biosciences Inc. (Pharmaceutical company). Phase: Therapeutic confirmatory (Phase III). Countries: Romania (ended), Czechia (ended), Spain (ended), Slovakia (ended), Germany (ended), Italy (ended).
Therapeutic area(s): Psychiatry and Psychology [F] - Mental Disorders [F03]
Gender: Female, Male. Age: 18-64 years, 65+ years. Enrolment: 199.
Status: Ended. End date (EU): 2023-11-08. End date: 2023-11-08. Decision date: 2023-06-07. Results received: Yes. Last updated: 2023-09-26.
Decision dates by country: CZ: 2023-06-15, IT: 2023-07-06, ES: 2023-06-22, SK: 2023-06-30, DE: 2023-07-05, RO: 2023-06-07

Condition(s): Schizophrenia
Product: Valbenazine, Placebo for Valbenazine Capsules, Valbenazine

Primary endpoint: Change in Positive and Negative Syndrome Scale (PANSS) Total Score from Baseline to Week 10 [Time Frame: Baseline, Week 10]
Endpoint(s): Change in Clinical Global Impression of Severity (CGI-S) Score from Baseline to Week 10 [Time Frame: Baseline, Week 10], Change in Personal and Social Performance (PSP) Score from Baseline to Week 10 [Time Frame: Baseline, Week 10]

Source: https://euclinicaltrials.eu/ctis-public/view/2022-502233-25-00